EU clinical trial 2025-521158-40-00: Total Neoadjuvant Therapy for lymph node-positive adenocarcinoma of the OESophagus and oesophagogastric junction: TNT-OES-2 trial
Protocol code: TNT-OES-2
Sponsor: Erasmus Universitair Medisch Centrum Rotterdam (Erasmus MC) (Hospital/Clinic/Other health care facility). Phase: Therapeutic exploratory (Phase II). Countries: Netherlands (ongoing, recruiting).
Therapeutic area(s): Analytical, Diagnostic and Therapeutic Techniques and Equipment [E] - Therapeutics [E02]; Diseases [C] - Digestive System Diseases [C06]
Gender: Female, Male. Age: 18-64 years, 65+ years. Enrolment: 216.
Status: Ongoing, recruiting. Start date (EU): 2025-09-12. Decision date: 2025-08-04. Results received: No. Last updated: 2026-05-01.

Condition(s): oesophageal cancer, oesophagogastric junction cancer
Product: Folinezuur Kalceks 10 mg/ml oplossing voor injectie/infusie, Paclitaxel Fresenius Kabi 6 mg/ml concentraat voor oplossing voor infusie, Carboplatin Accord 10 mg/ml, concentraat voor oplossing voor infusie, Docetaxel Eugia 20 mg/ml, concentraat voor oplossing voor intraveneuze infusie, Fluorouracil Accord 50 mg/ml, oplossing voor injectie of infusie, Oxaliplatine Fresenius Kabi 5 mg/ml concentraat voor oplossing voor infusie

Primary endpoint: • The progression-free survival defined as the time interval from randomization to the first event of local failure, regional failure, progression to metastatic disease or death
Endpoint(s): • Feasibility is defined as the proportion of patients that complete all 4 cycles of FLOT and all 5 chemotherapy cycles of CROSS, permitting dose reductions and delays, • Overall survival (OS), calculated from the date of randomization to the date of death due to any cause or, for patients alive at trial closure, date of last follow-up, • The number of patients with any major systemic therapy related toxicity, defined as grade ≥ 3 according to the Common Terminology Criteria for Adverse Events (CTCAE ) version 5.0), up to one month after the last administration of TNT (37), • The rate of any grade mucositis, up to one month after the last administration of TNT, • The number of patients requiring dose reductions or treatment delays during CROSS and FLOT, • The number of patients requiring G-CSF as primary or secondary prophylaxis, • The number of serious adverse events (SAEs), up to one month after last administration of TNT, • Surgical morbidity (Clavien-Dindo ≥3) and mortality (30-day, 90-day and/or in-hospital mortality), monitored within the Dutch upper gastrointestinal cancer audit (DUCA) surgical complications registry (38), • The proportion of resections that are radical (R0), microscopically irradical (R1) and macroscopically irradical (R2), • The proportion of patients that is unable to undergo oesophagectomy due to clinical deterioration, • The proportion of patients that choose for an active surveillance strategy instead of surgery after CRE-2, • Clinical complete response (cCR) rate is defined as the percentage of patients without residual locoregional disease or distant metastases at CRE-2, • Pathological complete response (pCR) rate in those who underwent an oesophagectomy is defined as ypT0N0, • Major pathological response in those who underwent oesophagectomy, defined as Mandard 1-2 (39), • The distant dissemination rate, defined as the proportion of metastases at 12 weeks after completion of TNT FLOT-CROSS or TNT CROSS-FLOT, detected by 18F-FDG, • Health-related quality of life (HRQoL), as measured by QoL questionnaires: EORTC QLQ-OG25 and EORTC-C30 (40, 41), • The PD-L1 CPS will be measured as a continuous variable. This will be measured using the 28-8 monoclonal antibody.

Source: https://euclinicaltrials.eu/ctis-public/view/2025-521158-40-00